EU clinical trial 2026-525978-19-00: A single and multiple dose trial assessing safety, tolerability, pharmacokinetics and pharmacodynamics of ZP6590
Protocol code: ZP6590-26033
Sponsor: Zealand Pharma A/S (Pharmaceutical company). Phase: Human Pharmacology (Phase I)- First administration to humans. Countries: Germany (ongoing, recruiting).
Therapeutic area(s): Diseases [C] - Nutritional and Metabolic Diseases [C18]
Gender: Male. Age: 18-64 years. Enrolment: 88.
Status: Ongoing, recruiting. Start date (EU): 2026-07-09. Decision date: 2026-06-24. Results received: No. Last updated: 2026-06-24.

Condition(s): Weight management

Source: https://euclinicaltrials.eu/ctis-public/view/2026-525978-19-00